EU clinical trial 2024-513194-44-00: A 6-week, International, Multicenter, Randomized, Double-blind, Parallel-group, Placebo-controlled Study of the Efficacy and Safety of Cariprazine in the Treatment of Adolescent Participants (13 to 17 years of age) with Schizophrenia
Protocol code: RGH-MD-20
Sponsor: Gedeon Richter Plc. (Pharmaceutical company). Phase: Therapeutic confirmatory (Phase III). Countries: Romania (ended), Bulgaria (ended).
Therapeutic area(s): Diseases [C] - Nervous System Diseases [C10]
Gender: Female, Male. Age: 0-17 years. Enrolment: 42.
Status: Ended. Start date (EU): 2021-12-14. End date (EU): 2026-04-14. Decision date: 2024-07-30. Results received: No. Last updated: 2026-01-16.
Decision dates by country: BG: 2024-08-06, RO: 2024-07-30

Condition(s): Adolescent Patients (13 to 17 years of age) with Schizophrenia
Product: Reagila 1.5 mg hard capsules, For the purpose of the clinical study a placebo formulation was prepared using the same white hard gelatine capsule shell., Reagila 3 mg hard capsules, Cariprazine 0.5 mg capsules, hard, Reagila 4.5 mg hard capsules

Primary endpoint: Primary efficacy endpoint: Change from baseline to Week 6 on the PANSS total score
Endpoint(s): Comparison of AEs, clinical laboratory measures, vital signs, ECG, C-SSRS, CDSS, AIMS, BARS, SAS, UKU, menstrual cycle assessment, physical examination, and Tanner staging in cariprazine exposed participants versus placebo exposed participants

Source: https://euclinicaltrials.eu/ctis-public/view/2024-513194-44-00